EU clinical trial 2024-517651-12-00: Phase I/II dose escalation trial of radiodynamic therapy (RDT) with 5-Aminolevulinic acid in patients with first recurrence of glioblastoma
Sponsor: Universitaet Muenster (Educational Institution). Phase: Phase I and Phase II (Integrated)- Other. Countries: Germany (ongoing, recruiting).
Therapeutic area(s): Diseases [C] - Neoplasms [C04]
Gender: Female, Male. Age: 18-64 years, 65+ years. Enrolment: 33.
Status: Ongoing, recruiting. Start date (EU): 2022-10-28. Decision date: 2024-10-17. Results received: No. Last updated: 2026-06-18.

Condition(s): recurrent glioblastoma
Product: Gliolan 30 mg/ml powder for oral solution.

Primary endpoint: MTD is defined as the most frequent repetitive dose of 5-ALA during 4 weeks of fractionated conformal radiotherapy that does not cause unacceptable side effects, i.e. repeated dose at which no more than 1 of 6 patients suffers a dose-limiting toxicity (DLT). • Toxicological safety of repeat doses of 5-ALA • Neurological safety of RDT • Dermatological safety of RDT • Assess all new AEs CTC AE grade 2 or higher

Source: https://euclinicaltrials.eu/ctis-public/view/2024-517651-12-00